EU clinical trial 2022-501343-33-00: (21492 ARASTEP) A randomized, double-blind, placebo-controlled Phase 3 study of darolutamide plus androgen deprivation therapy (ADT) compared with placebo plus ADT in patients with high-risk biochemical recurrence (BCR) of prostate cancer
Protocol code: 21492
Sponsor: Bayer Consumer Care AG, Bayer AG (Pharmaceutical company). Phase: Therapeutic confirmatory (Phase III). Countries: Spain (ongoing, recruitment ended), Denmark (ongoing, recruitment ended), Italy (ongoing, recruitment ended), Sweden (ongoing, recruitment ended), Finland (ongoing, recruitment ended), Germany (ongoing, recruitment ended), Austria (ongoing, recruitment ended), France (ongoing, recruitment ended), Belgium (ongoing, recruitment ended), Czechia (ongoing, recruitment ended), Hungary (ongoing, recruitment ended), Portugal (ongoing, recruitment ended), Netherlands (ongoing, recruitment ended), Poland (ongoing, recruitment ended).
Therapeutic area(s): Diseases [C] - Male Urogenital Diseases [C12]
Gender: Male. Age: 18-64 years, 65+ years. Enrolment: 562.
Status: Ongoing, recruitment ended. Start date (EU): 2023-10-18. Decision date: 2023-07-25. Results received: No. Last updated: 2026-06-15.
Decision dates by country: CZ: 2024-06-10, FR: 2023-07-31, SE: 2023-07-27, DK: 2023-07-25, ES: 2023-07-26, FI: 2023-07-25, BE: 2024-05-24, HU: 2024-06-05, PL: 2024-06-10, NL: 2024-05-06, IT: 2023-07-26, PT: 2024-06-03, AT: 2023-07-31, DE: 2023-07-26

Condition(s): Biochemically recurrent prostate cancer
Product: Pylclari 1 000 MBq/mL solution for injection, Gallium (68Ga) PSMA-11 (gozetotide) prepared using PSMA-11 Sterile Cold Kit, Placebo of BAY 1841788, BAY 1841788

Primary endpoint: rPFS by PSMA PET/CT assessed by BICR
Endpoint(s): MFS by CI assessed by BICR, Time to CRPC, Time to initiation of first subsequent systemic antineoplastic therapy, Time to loco-regional progression by PSMA PET/CT, Time to first SSE, OS, PSA undetectable rates (<0.2 ng/mL) at 12 months, Time to deterioration in the FACT-P total score, Number of participants with TEAEs and TESAEs categorized by severity, Number of participants who discontinue study treatment due to a TEAE, Time to symptomatic progression

Source: https://euclinicaltrials.eu/ctis-public/view/2022-501343-33-00